EU clinical trial 2023-506967-33-00: CONCISE COlchicine iN Circulating Inflammatory markers after StrokE
Protocol code: CONCISE
Sponsor: University College Dublin (Educational Institution). Phase: Therapeutic exploratory (Phase II). Countries: Ireland (ended).
Therapeutic area(s): Diseases [C] - Cardiovascular Diseases [C14]
Gender: Female, Male. Age: 18-64 years, 65+ years. Enrolment: 120.
Status: Ended. End date (EU): 2024-11-19. Decision date: 2024-02-16. Results received: Yes. Last updated: 2024-04-18.
Decision dates by country: IE: 2024-04-18

Condition(s): Stroke
Product: Colchicine Tiofarma 500 microgram Tablets

Primary endpoint: The primary endpoint is the difference in mean or median change in inflammatory biomarker panel from baseline to end of treatment
Endpoint(s): The secondary endpoint is the proportion of patients at the end of treatment whose hsCRP level is suppressed below 2mg/L. Description of changes in inflammatory markers after treatment will also be a secondary analysis. Secondary endpoints will also include proportion of patients who discontinue colchicine treatment due to poor tolerability and prevalence of adverse events associated with colchicine treatment.

Source: https://euclinicaltrials.eu/ctis-public/view/2023-506967-33-00